EU clinical trial 2023-506450-20-00: A Randomized, Head-to-head, Single-blind Study to Compare the Response to Treatment with Subcutaneous Abatacept vs Adalimumab, on Background Methotrexate, in Adults with Early, Seropositive Rheumatoid Arthritis Who Have "Shared Epitope" HLA Class II Risk Alleles and Have an Inadequate Response to Methotrexate
Protocol code: IM101-863
Sponsor: Bristol-Myers Squibb Services Unlimited Company (Pharmaceutical company). Phase: Therapeutic confirmatory (Phase III). Countries: France (ended), Poland (ongoing, recruitment ended), Italy (ended), Spain (ended), Czechia (ended), Germany (ended).
Therapeutic area(s): Diseases [C] - Immune System Diseases [C20]
Gender: Female, Male. Age: 18-64 years, 65+ years. Enrolment: 141.
Start date (EU): 2021-11-05. Decision date: 2024-01-26. Results received: No. Last updated: 2026-03-02.
Decision dates by country: CZ: 2024-01-30, FR: 2024-01-26, DE: 2024-01-30, IT: 2024-02-26, ES: 2024-01-29, PL: 2024-01-29

Condition(s): Rheumatoid Arthritis
Product: Humira 40 mg solution for injection in pre-filled syringe, Abatacept

Primary endpoint: Proportion of SE+ participants meeting ACR50 response at Week 24
Endpoint(s): Proportion of SE+ participants achieving DAS28-CRP remission (DAS28-CRP < 2.6) at Week 24, Proportion of whole study population participants meeting ACR50 response at Week 24, Proportion of SE+ participants achieving CDAI remission (CDAI ≤ 2.8) at Week 24, Mean change from baseline in SE+ participant-reported pain (VAS) at Week 24, Proportion of SE+ subset and whole population achieving ACR20/50/70 responses, DAS remission, CDAI remission, SDAI remission over the SBTP and OLTP; mean changes from baseline in DAS28-CRP, CDAI, SDAI over the SBTP and OLTP; mean changes from baseline in the 7 ACR core components over the SBTP and OLTP, Mean change from baseline in SF-36 in SE+ subset and whole population at Week 24 and Week 104 (4 physical and 4 mental subscales and the physical component and mental component summary)

Source: https://euclinicaltrials.eu/ctis-public/view/2023-506450-20-00